EU clinical trial 2023-509261-20-00: Modulation of the Extent of Ischemic Brain Damage by Protecting the Endothelial Glycocalyx with Low-Dose Albumin Administration (MOZEG)
Protocol code: MOZEG
Sponsor: Fakultni Nemocnice Hradec Kralove (Hospital/Clinic/Other health care facility). Phase: Therapeutic exploratory (Phase II). Countries: Czechia (ongoing, recruiting).
Therapeutic area(s): Diseases [C] - Cardiovascular Diseases [C14]; Diseases [C] - Nervous System Diseases [C10]
Gender: Female, Male. Age: 18-64 years, 65+ years. Enrolment: 100.
Status: Ongoing, recruiting. Start date (EU): 2026-02-09. Decision date: 2025-03-26. Results received: No. Last updated: 2025-03-26.

Condition(s): Ischemic stroke
Product: Sodium chloride Fresenius Kabi 0,9% infuzní roztok, HUMAN ALBUMIN SOLUTION

Primary endpoint: Concentration of syndecan-1 in blood serum, Concentration of GAG in urine.
Endpoint(s): Mortality of enrolled patients on Day 90, Size of the ischemic brain lesion in patients with iCMP after low-dose albumin administration on control CT (MRI in exceptional cases)., Modified Rankin Scale (mRS) scores before the onset of iCMP and on Day 90., Neurological examination scores at screening and on Day 7/before discharge/transfer from the hospital

Source: https://euclinicaltrials.eu/ctis-public/view/2023-509261-20-00